EU clinical trial 2026-526395-23-00: CLINIC-CURE, a pilot exploratory clinical trial of analytical treatment interruption in people with HIV with a highly favorable profile
Protocol code: CLINIC-CURE
Sponsor: Fundacio De Recerca Clinic Barcelona-Institut D’Investigacions Biomediques August Pi I Sunyer (Laboratory/Research/Testing facility). Phase: Therapeutic use (Phase IV). Countries: Spain (authorised, recruitment pending).
Therapeutic area(s): Diseases [C] - Virus Diseases [C02]
Gender: Female, Male. Age: 18-64 years. Enrolment: 20.
Status: Authorised, recruitment pending. Decision date: 2026-08-06. Results received: No. Last updated: 2026-08-06.

Condition(s): HIV
Product: EMTRICITABINE, TENOFOVIR ALAFENAMIDE AND BICTEGRAVIR

Primary endpoint: Proportion of individuals with VL<50 copies at 24 weeks of ATI.
Endpoint(s): Proportion of participants with VL < 200, <400 copies/ml and VL <1000 copies/ml at 24 weeks post-ATI., Time (in weeks) to viral rebound (VL≥ 50)., Proportion of participants with any clinical symptom or retroviral syndrome during ATI., Evolution of the viral reservoir as measured by IPDA and intracellular viral RNA at weeks 0,4,12, 24,36 and 48., Viral inhibition "in vitro" (VIA assays) culturing CD4 lymphocytes in the presence of CD8 and/or NK lymphocytes at weeks 0, 4, 12, 24., 36 and 48., Assessment by flow-cytometry of lymphocytic subpopulations, NK memory-like lymphocytes defined as CD57+CD56+dim, NKG2C+, KIR3DL1+ and γδ-CD8 subsets at weeks 0, 4, 12,24, 36 and 48., Characterization of the cytotoxic activity of CD4, CD8 and cellular proliferation after stimulation with HIV peptides at weeks 4, 12, 24, 36 and 48 as compared to basal levels., Cytotoxic activity of NK cells as assessed by anti-HIV peptide responses, granzyme production and killing of K562 and Raji cells at weeks 0, 4, 12, 24, 36 and 48., Transcriptomic findings in different lymphocyte subsets by NGS at weeks 0, 4, 12, 24, 36 and 48., Evolution of markers of inflammation, immunesenesce and immune activation in sera at weeks 0, 4, 12, 24, 36 and 48., Generation of autologous neutralizing antibodies at weeks 4, 8, 12, 24, 36 and 48 in comparison with basal levels., Integration of clinical, genetic, immunologic and virologic parameters to generate a predictive model of post- treatment control.

Source: https://euclinicaltrials.eu/ctis-public/view/2026-526395-23-00